EU clinical trial 2024-514763-25-01: A Phase 1 Study of ARO-ATXN2 Injection in Adults With Spinocerebellar Ataxia Type 2
Protocol code: AROATXN2-1001
Sponsor: Arrowhead Pharmaceuticals Inc. (Pharmaceutical company). Phase: Human Pharmacology (Phase I)- First administration to humans. Countries: France (ongoing, recruiting), Spain (ongoing, recruiting), Italy (authorised, recruiting), Germany (authorised, recruiting).
Therapeutic area(s): Diseases [C] - Nervous System Diseases [C10]
Gender: Female, Male. Age: 18-64 years, 65+ years. Enrolment: 16.
Start date (EU): 2025-12-04. Decision date: 2025-05-13. Results received: No. Last updated: 2026-07-13.
Decision dates by country: FR: 2025-05-14, ES: 2025-05-13, IT: 2025-05-15, DE: 2025-05-14

Condition(s): spinocerebellar ataxia type 2

Source: https://euclinicaltrials.eu/ctis-public/view/2024-514763-25-01